EU clinical trial 2025-524914-26-00: A Phase II, Randomized, Double-blind, 3-Period Cross-over, Dose‑ranging Study to Assess the Efficacy and Safety of Glycopyrronium (GP) versus Placebo in Participants of 4 to Less than 12 Years of Age with Asthma Receiving Background Budesonide and Formoterol Fumarate (BFF) (FAROS)
Protocol code: D5982C00015
Sponsor: AstraZeneca AB (Pharmaceutical company). Phase: Therapeutic exploratory (Phase II). Countries: Czechia (authorised, recruitment pending), Poland (authorised, recruitment pending), Hungary (authorised, recruiting).
Therapeutic area(s): Diseases [C] - Respiratory Tract Diseases [C08]
Gender: Female, Male. Age: 0-17 years. Enrolment: 35.
Start date (EU): 2026-07-28. Decision date: 2026-07-01. Results received: No. Last updated: 2026-07-06.
Decision dates by country: CZ: 2026-07-01, HU: 2026-07-06, PL: 2026-07-06

Condition(s): Asthma
Product: BFF (PT009), Placebo MDI

Primary endpoint: Change from baseline in FEV1 at 1 hour post-dose measured at EoT (at 3 weeks).
Endpoint(s): Change from baseline in morning pre-dose trough FEV1 at EoT (at 3 weeks).

Source: https://euclinicaltrials.eu/ctis-public/view/2025-524914-26-00